EU clinical trial 2024-516061-36-00: A Phase 2 Study of Isatuximab in combination with Bortezomib, Cyclophosphamide and Dexamethasone followed by isatuximab and lenalidomide maintenance in Newly Diagnosed Patients with Multiple Myeloma and severe Renal Impairment
Protocol code: EAE116
Sponsor: Hellenic Society Of Hematology (Patient organisation/association). Phase: Therapeutic exploratory (Phase II). Countries: Greece (ended).
Therapeutic area(s): Diseases [C] - Neoplasms [C04]
Gender: Female, Male. Age: 18-64 years, 65+ years. Enrolment: 51.
Status: Ended. Start date (EU): 2022-07-28. End date (EU): 2025-07-03. Decision date: 2024-12-09. Results received: Yes. Last updated: 2025-03-21.

Condition(s): Newly diagnosed patients with multiple myeloma and severe renal impairment
Product: CYCLOPHOSPHAMIDE MONOHYDRATE, BORTEZOMIB, ISATUXIMAB, LENALIDOMIDE, DEXAMETHASONE, DEXAMETHASONE

Primary endpoint: The renal response rate (RRR) at six months of treatment with isatuximab plus VCd. RRR is defined as the proportion of patients who achieve a partial renal
Endpoint(s): 1.Overall response rate (ORR): The proportion of patients who achieve a partial response (PR) or better, assessed by the Investigator using the IMWG criteria, from study treatment initiation to PD, or the initiation of further anti-myeloma treatment, or death, whichever comes first, 2.Progression-free survival (PFS): The time from study treatment initiation to the date of first documentation of PD, assessed by the Investigator using the IMWG response criteria, or the initiation of further anti-myeloma treatment, or death from any cause, whichever comes first, 3.Time to Response (TTR): The time from study treatment initiation to the date of the first objective response of partial response (PR) or better, assessed with the IMWG response criteria, 4.Duration of Response (DoR): - The time from the date of the first objective response to the date of first documented PD, assessed by the Investigator using the IMWG response criteria, or death, whichever occurs first. -DoR will be assessed only for patients who have achieved ≥PR, 5.Overall Survival (OS): The time from study treatment initiation to the date of death from any cause. -OS will be assessed during the response follow-up visits, and for a maximum of 36 months from first patient enrolment., 6.Minimal Residual Disease (MRD) negativity rate: The proportion of patients achieving MRD-negative status, assessed by the Investigator at suspected CR as per IMWG criteria., 7.Safety: The incidence of AEs, TEAEs, and serious adverse events (SAEs) from study treatment initiation until 30 days after the last study treatment. AEs and laboratory parameters will be graded using the NCICTCAE version 4.03. Specific safety laboratory tests are planned in case of an infusion reaction

Source: https://euclinicaltrials.eu/ctis-public/view/2024-516061-36-00